EU clinical trial 2024-512180-31-00: Efficacy of PErioperative PEmbrolizumab treatment in patients with resectable metastases from kidney cancer. The PE-PE study
Protocol code: PE-PE
Sponsor: Consorzio Oncotech (Pharmaceutical company). Phase: Therapeutic exploratory (Phase II). Countries: Italy (ongoing, recruitment ended).
Therapeutic area(s): Diseases [C] - Neoplasms [C04]
Gender: Female, Male. Age: 18-64 years, 65+ years. Enrolment: 81.
Status: Ongoing, recruitment ended. Start date (EU): 2025-03-14. Decision date: 2024-09-23. Results received: No. Last updated: 2026-05-29.

Condition(s): Oligometastatic renal cell carcinoma
Product: KEYTRUDA 25 mg/mL concentrate for solution for infusion

Primary endpoint: To assess the relapsed free survival (RFS) defined as the length of time from the randomization and the appearance of radiological progression of kidney cancer in patients who received pembrolizumab compared to those who did not.
Endpoint(s): • To assess the distant relapsed free survival (dRFS) in patients who received pembrolizumab compared to those who did not. The dRFS was defined as the length of time from the randomization to the appearance of distant metastases outside those treated with surgery or radiotherapy, • To assess the overall survival defined as the time from the randomization to the patient’s death or last contact in patients who received pembrolizumab compared to those who did not., • To assess the overall incidence of adverse events in patients who received pembrolizumab compared to those who did not., • To assess the overall incidence local progression in patients who received pembrolizumab plus RT compared to those who received RT alone.

Source: https://euclinicaltrials.eu/ctis-public/view/2024-512180-31-00